EU clinical trial 2023-503418-63-00: A Randomized, Phase 2, Open-Label, Multi-Arm Study of Tislelizumab in Combination With Investigational Agents as First-Line Treatment in Patients With Recurrent or Metastatic Head and Neck Squamous Cell Carcinoma
Protocol code: BGB-HNSCC-201
Sponsor: BeOne Medicines AG (Pharmaceutical company). Phase: Therapeutic exploratory (Phase II). Countries: France (ended), Italy (ended), Spain (ended).
Therapeutic area(s): Diseases [C] - Neoplasms [C04]
Gender: Female, Male. Age: 18-64 years, 65+ years. Enrolment: 28.
Status: Ended. Start date (EU): 2023-11-23. End date (EU): 2026-03-10. End date: 2026-07-23. Decision date: 2023-10-27. Results received: No. Last updated: 2026-03-23.
Decision dates by country: FR: 2023-10-27, IT: 2023-10-30, ES: 2023-10-30

Condition(s): Head and Neck Squamous Cell Carcinoma
Product: BGB-A425, LBL-007, Tislelizumab

Primary endpoint: Confirmed objective response rate (ORR) as assessed by the investigators per Response Evaluation Criteria in Solid Tumors (RECIST) Version (v)1.1.
Endpoint(s): Progression-free survival (PFS), duration of response (DOR), clinical benefit rate (CBR), and disease control rate (DCR) as assessed by the investigators per RECIST v1.1., The incidence and severity of adverse events (AEs) according to National Cancer Institute Common Terminology Criteria for Adverse Events Version 5.0 (NCI-CTCAE v5.0) in reference arm (tislelizumab alone) and experimental arms (tislelizumab plus investigational agent[s])., Overall Survival (OS).

Source: https://euclinicaltrials.eu/ctis-public/view/2023-503418-63-00